EU clinical trial 2023-509746-35-00: A Phase 2, multicenter, randomized, double-blind, placebo-controlled, parallel-group trial to investigate the efficacy and safety of daxdilimab subcutaneous injection in reducing disease activity in adult participants with moderate-to-severe primary discoid lupus erythematosus.
Protocol code: HZNP-DAX-202
Sponsor: Horizon Therapeutics Ireland Designated Activity Company (Pharmaceutical company). Phase: Therapeutic exploratory (Phase II). Countries: Denmark (ended), France (ended), Czechia (ended), Germany (ended), Poland (ended), Greece (ended), Bulgaria (ended).
Therapeutic area(s): Diseases [C] - Immune System Diseases [C20]
Gender: Female, Male. Age: 18-64 years, 65+ years. Enrolment: 36.
Status: Ended. Start date (EU): 2023-05-16. End date (EU): 2025-05-09. End date: 2025-05-09. Decision date: 2024-05-30. Results received: Yes. Last updated: 2025-07-31.
Decision dates by country: GR: 2024-08-19, FR: 2024-05-30, DE: 2024-06-03, DK: 2024-05-31, PL: 2024-06-10, BG: 2024-06-19, CZ: 2024-05-30

Condition(s): Primary Discoid Lupus Erythematosus
Product: Placebo: Normal Saline - Solution for injection, Daxdilimab

Primary endpoint: Primary Efficacy: Mean change in CLASI-A score from Baseline (Day 1) to Week 24
Endpoint(s): Secondary Efficacy: Proportion of participants who achieve 0 or 1 on the CLA-IGA scale at Week 24 (5-point Likert scale [0-4])., Secondary Efficacy: Proportion of participants who achieve a ≥ 50% reduction in CLASI-A score from Baseline (Day 1) at Week 24., Secondary Efficacy: Mean change in the SADDLE from Baseline (Day 1) to Week 24., Pharmacokinetics and Immunogenicity: Serum concentration of daxdilimab over time., Pharmacokinetics and Immunogenicity: Incidence of ADA directed against daxdilimab over time., Safety: Incidence of TEAEs., Safety: Incidence of TESAEs, Safety: Incidence of TEAESIs: hypersensitivity reaction, including anaphylaxis, herpes zoster infection, serious (Grade 3 or higher) viral infection/reactivation, opportunistic infection, and malignancy (except non-melanoma skin cancer).

Source: https://euclinicaltrials.eu/ctis-public/view/2023-509746-35-00